EU clinical trial 2025-523151-66-00: Early Lyophilised plasma In Patients with haemorrhagic Shock (ELIPS-Trial)
Sponsor: Johannes Kepler University Linz (Educational Institution). Phase: Therapeutic use (Phase IV). Countries: Austria (ongoing, recruiting).
Therapeutic area(s): Analytical, Diagnostic and Therapeutic Techniques and Equipment [E] - Anesthesia and Analgesia [E03]
Gender: Female, Male. Age: 18-64 years, 65+ years. Enrolment: 30.
Status: Ongoing, recruiting. Start date (EU): 2026-03-14. Decision date: 2026-01-26. Results received: No. Last updated: 2026-01-26.

Condition(s): Haemorrhagic shock
Product: ELO-MEL isoton - Infusionslösung, LyoPlas N - W

Source: https://euclinicaltrials.eu/ctis-public/view/2025-523151-66-00